EU clinical trial 2022-502012-37-00: A Phase IIIb Single Arm, Open-label, Multicentre Study of Durvalumab and Tremelimumab as First Line Treatment in Participants with Advanced Hepatocellular Carcinoma (SIERRA)
Protocol code: D419CR00030
Sponsor: AstraZeneca AB (Pharmaceutical company). Phase: Therapeutic confirmatory (Phase III). Countries: Germany (ended), Spain (ended), France (ended), Italy (ongoing, recruitment ended).
Therapeutic area(s): Diseases [C] - Neoplasms [C04]
Gender: Female, Male. Age: 18-64 years, 65+ years. Enrolment: 89.
Start date (EU): 2023-10-06. Decision date: 2023-08-02. Results received: No. Last updated: 2026-04-21.
Decision dates by country: DE: 2023-08-04, ES: 2023-08-04, IT: 2023-08-02, FR: 2023-08-07

Condition(s): Advanced Hepatocellular Carcinoma
Product: MYCOPHENOLATE MOFETIL, IMJUDO 20 mg/ml concentrate for solution for infusion., IMFINZI 50 mg/mL concentrate for solution for infusion., Inflectra 100 mg powder for concentrate for solution for infusion

Primary endpoint: • Incidence of Grade 3/4 PRAEs as observed within 6 months after the initiation of study intervention. A PRAE is defined as an AE that has been assessed by the investigator to be possibly related to study intervention., • ORR, defined as the proportion of participants who have a confirmed CR or PR, as determined by the investigator per RECIST 1.1.
Endpoint(s): Incidence, severity, nature, seriousness, intervention/treatment, outcome and causality of AEs, including PRAEs, AESIs, imAEs, SAEs, AEs resulting in treatment interruption and discontinuation, and laboratory findings., • Median OS, OS12, and OS24. OS is defined as the time from the date of the first dose of study intervention until death due to any cause., • Median PFS, PFS12, and PFS18. PFS is defined as the time from the first dose of study intervention until the date of PD per RECIST 1.1, as assessed by the investigator, or death due to any cause, • DCR-16 and DCR-24, defined as the percentage of participants who have a best objective response of CR or PR by Week 16/24 or who have demonstrated SD per RECIST 1.1, as assessed by the investigator for at least 16/24 weeks following the start of study intervention., • DOR, defined as the time from the date of first documented response until the date of documented progression per RECIST 1.1, as assessed by the investigator, or death due to any cause., • DOT, defined as the time on study intervention., EORTC QLQ-C30: • Time to deterioration in global health status/QoL, functioning (physical), multiterm symptom (fatigue), single-item symptoms (appetite loss, nausea)., EORTC QLQ-C30: • Clinically meaningful change from baseline in global health status/QoL, symptoms and function score (categorised as improvement, no change or deterioration) at each post-baseline assessment, EORTC QLQ-C30: • Best overall response for global health status/QoL, function and symptom (fatigue), EORTC QLQ-C30: • Change from baseline of global health status/QoL, symptom and functioning scores at each post-baseline assessment., EORTC QLQ-HCC18: • Time to deterioration in single-item symptoms (shoulder pain, abdominal pain, abdominal swelling), EORTC QLQ-HCC18: • Clinically meaningful change from baseline (categorised as improvement, no change or deterioration) at each post-baseline assessment, EORTC QLQ-HCC18: • Best overall response in single-item symptoms (shoulder pain, abdominal pain, abdominal swelling), EORTC QLQ-HCC18: • Change from baseline for each EORTC QLQ-HCC18 scale/item score at each post-baseline assessment.

Source: https://euclinicaltrials.eu/ctis-public/view/2022-502012-37-00